EU clinical trial 2024-514844-10-00: RB SFCE 2009 : Adjuvant treatment in extensive unilateral retinoblastoma primary enucleated
Protocol code: IC 2009-04
Sponsor: Institut Curie (Hospital/Clinic/Other health care facility). Phase: Therapeutic exploratory (Phase II). Countries: France (ongoing, recruitment ended).
Therapeutic area(s): Diseases [C] - Eye Diseases [C11]
Gender: Female, Male. Age: 0-17 years. Enrolment: 195.
Status: Ongoing, recruitment ended. Start date (EU): 2010-03-18. Decision date: 2024-08-14. Results received: No. Last updated: 2025-07-01.

Condition(s): Retinoblastoma
Product: ONCOVIN 1 mg, solution injectable, CARBOPLATINE TEVA 10 mg/ml, solution pour perfusion, ENDOXAN 1000 mg, poudre pour solution injectable, ETOPOSIDE TEVA 20 mg/ml, solution à diluer pour perfusion, TEPADINA 15 mg powder for concentrate for solution for infusion, THIOTEPA GENOPHARM 15 mg, lyophilisat pour usage parentéral

Primary endpoint: Rate of extra ocular relapses
Endpoint(s): Evaluate long term and acute toxicities of adjuvant chemotherapy and orbital irradiation., Number of patient with secondary bilateralisation, Evaluate the different histopathological risk factors frequency., To determine tumors genomic., Evaluate sensitivity of MRI in detecting extra ocular extension.

Source: https://euclinicaltrials.eu/ctis-public/view/2024-514844-10-00